EU clinical trial 2022-501753-36-00: A Phase 3, Double-Blind, Randomized, Placebo-Controlled, Efficacy and Safety Study of Povorcitinib (INCB054707) in Participants With Moderate to Severe Hidradenitis Suppurativa
Protocol code: INCB 54707-302
Sponsor: Incyte Corp. (Pharmaceutical company). Phase: Therapeutic confirmatory (Phase III). Countries: Poland (ended), Germany (ended), Bulgaria (ended), France (ended), Denmark (ended), Italy (ended), Spain (ended).
Therapeutic area(s): Diseases [C] - Immune System Diseases [C20]
Gender: Female, Male. Age: 18-64 years, 65+ years. Enrolment: 291.
Status: Ended. Start date (EU): 2023-06-02. End date (EU): 2025-11-18. End date: 2025-11-21. Decision date: 2023-05-12. Results received: No. Last updated: 2025-11-25.
Decision dates by country: BG: 2023-05-15, ES: 2023-05-12, IT: 2023-05-15, PL: 2023-05-15, FR: 2023-05-15, DK: 2023-05-12, DE: 2023-05-15

Condition(s): Hidradenitis Suppurativa
Product: Povorcitinib, Povorcitinib, Matching formulation of Povorcitinib (INCB054707) oral tablets

Primary endpoint: Proportion of participants who achieve Hidradenitis Suppurativa Clinical Response (HiSCR) at Week 12
Endpoint(s): Proportion of participants who achieve Hidradenitis Suppurativa Clinical Response 75 (HiSCR75) at Week 12, Proportion of participants with flare by Week 12, Proportion of participants who achieve Skin Pain NRS30 at Week 12 among participants with baseline Skin Pain NRS score ≥ 3, Proportion of participants with a ≥ 3-point decrease in Skin Pain NRS score at Week 12 among participants with baseline Skin Pain NRS score ≥ 3, Proportion of participants with at least a 4-point increase from baseline in Functional Assessment of Chronic Illness Therapy – Fatigue (FACIT-F) score at Week 12, Mean change from baseline in Dermatology Life Quality Index (DLQI) score at each visit, Mean change from baseline in abscess count at each visit, Percentage change from baseline in abscess count at each visit, Mean change from baseline in inflammatory nodule count at each visit, Percentage change from baseline in inflammatory nodule count at each visit, Mean change from baseline in draining tunnel count at each visit, Percentage change from baseline in draining tunnel count at each visit, Proportion of participants who achieve HiSCR at Week 24, Proportion of participants who achieve HiSCR75 at Week 24, Proportion of participants with flare by Week 24, Proportion of participants who achieved Skin Pain NRS30 at Week 24 among participants with baseline Skin Pain NRS score ≥ 3, Proportion of participants who achieve HiSCR at Week 54, Proportion of participants who achieve HiSCR75 at Week 54, Proportion of participants with flare by Week 54, Proportion of participants who achieved Skin Pain NRS30 at Week 54 among participants with baseline Skin Pain NRS score ≥ 3, Proportion of participants who achieve maintenance of HiSCR or greater response at each visit during the EXT period, Proportion of participants who achieve maintenance of HiSCR75 or greater response at each visit during the EXT period

Source: https://euclinicaltrials.eu/ctis-public/view/2022-501753-36-00